EU clinical trial 2022-501102-35-00: A translational RANDOMIZED phase III study exploring the effect of the addition of capecitabine to Carboplatinum based chemotherapy in early “triple negative” breast cancer
Protocol code: NordicTrip
Sponsor: Region Skåne (Hospital/Clinic/Other health care facility). Phase: Therapeutic confirmatory (Phase III). Countries: Sweden (ongoing, recruitment ended), Denmark (ongoing, recruitment ended).
Therapeutic area(s): Diseases [C] - Neoplasms [C04]
Gender: Female, Male. Age: 18-64 years, 65+ years. Enrolment: 325.
Status: Ongoing, recruitment ended. Start date (EU): 2019-12-02. Decision date: 2024-06-05. Results received: No. Last updated: 2025-07-08.
Decision dates by country: SE: 2024-06-05, DK: 2024-06-06

Condition(s): Early triple negative breast cancer
Product: CAPECITABINE, PACLITAXEL, KEYTRUDA 25 mg/mL concentrate for solution for infusion, EPIRUBICIN, CYCLOPHOSPHAMIDE, CARBOPLATIN

Primary endpoint: pCR with the addition of capecitabine compared with carboplatin-based chemotherapy alone.
Endpoint(s): Invasive Disease Survival (IDFS) with the addition of capecitabine compared with carboplatin-based chemotherapy alone., Breast Cancer Specific Survival (BCSS) with the addition of capecitabine compared with carboplatin-based chemotherapy alone., Overall Survival (OS) with the addition of capecitabine compared with carboplatin-based chemotherapy alone.

Source: https://euclinicaltrials.eu/ctis-public/view/2022-501102-35-00